EU clinical trial 2024-518520-77-00: Open label extension study for monitoring long-term safety in patients with Myoclonic Astatic Epilepsy (Doose-Syndrome) receiving Fenfluramine as add-on therapy
Sponsor: Universitaetsklinikum Schleswig-Holstein AöR (Hospital/Clinic/Other health care facility). Phase: Therapeutic exploratory (Phase II). Countries: Germany (authorised, recruiting).
Therapeutic area(s): Diseases [C] - Nervous System Diseases [C10]
Gender: Female, Male. Age: 0-17 years. Enrolment: 10.
Status: Authorised, recruiting. Start date (EU): 2021-11-24. Decision date: 2024-10-24. Results received: No. Last updated: 2026-04-14.

Condition(s): Myclonic-astatic epilepsy
Product: Fintepla 2.2 mg/ml oral solution

Primary endpoint: Efficacy Endpoint. Change of individual (per subject) number and frequency of countable seizures compared to the baseline visit of the previous FFA-MAE study (before onset of Fenfluramine treatment), Safety: (Serious) Adverse Events; Laboratory measurements; Vital signs; Physical examination; 12-lead electrocardiogram (ECGs); Doppler echocardiogram (ECHOs); Body weight

Source: https://euclinicaltrials.eu/ctis-public/view/2024-518520-77-00